EU clinical trial 2023-508119-22-00: A Sub Study to Learn About the Study Medication Called Etrasimod Tablets in a Hybrid Decentralized Clinical Trial Setting
Protocol code: C5041050
Sponsor: Pfizer Inc. (Pharmaceutical company). Phase: Human Pharmacology (Phase I)- Other. Countries: Belgium (ended).
Therapeutic area(s): Diseases [C] - Immune System Diseases [C20]
Gender: Female, Male. Age: 18-64 years, 65+ years. Enrolment: 8.
Status: Ended. Start date (EU): 2023-12-18. End date (EU): 2024-03-01. End date: 2024-03-02. Decision date: 2023-10-26. Results received: No. Last updated: 2024-03-27.

Condition(s): immune-mediated inflammatory disorders, including ulcerative colitis, alopecia areata, atopic dermatitis, and eosinophilic esophagitis

Source: https://euclinicaltrials.eu/ctis-public/view/2023-508119-22-00